EU clinical trial 2023-510063-35-00: Phase 1/1b Study of the Safety, Pharmacokinetics, Pharmacodynamics and Preliminary Clinical Activity of Lunresertib Alone or in Combination with RP-3500 or Debio 0123 in Patients with Advanced Solid Tumors (MYTHIC Study)
Protocol code: Debio 0123-106
Sponsor: Debiopharm International S.A. (Pharmaceutical company). Phase: Human Pharmacology (Phase I)- First administration to humans. Countries: Denmark (ongoing, recruiting), France (not authorised), Spain (authorised, recruitment pending), Netherlands (ended).
Therapeutic area(s): Diseases [C] - Neoplasms [C04]
Gender: Female, Male. Age: 0-17 years, 18-64 years, 65+ years. Enrolment: 63.
Start date (EU): 2024-03-13. Decision date: 2024-03-12. Results received: No. Last updated: 2026-06-08.
Decision dates by country: NL: 2024-10-21, ES: 2024-09-30, DK: 2024-03-12

Condition(s): Advanced solid tumors harboring either CCNE1 amplification or deleterious mutations in either FBXW7 or PPP2R1A
Product: Debio 2513, Debio 2513, Debio 0123, Debio 2513, Debio 0123, Debio 0123, Debio 0123, Debio 0123, Debio 0123

Primary endpoint: Incidence and severity of treatment-emergent adverse events (TEAEs), laboratory assessments, vital signs, electrocardiograms (ECGs), and use of concomitant medications., Dose-limiting toxicities (DLTs), Module 2: Treatment-emergent adverse events (TEAEs), physical examinations (PEs), safety laboratory assessments, electrocardiograms (ECGs), and vital sign measurements, Module 2: DoseFor MTD: incidence of dose-limiting toxicities (DLTs) For RP2D: incidence and severity of cumulative safety data, Module 3: Plasma concentrations of lunresertib with calculation of Cmax, Tmax, AUC, elimination t1/2, and other PK parameters as appropriate, Module 3: DLTs, TEAEs, safety laboratory assessments For MTD: incidence of DLTs For RP2D: incidence and severity of cumulative safety data, Module 4: Treatment-emergent adverse events (TEAEs), physical examinations (PEs), safety laboratory assessments, electrocardiograms (ECGs), and vital sign measurements, Module 4: For MTD: incidence of Dose limiting toxicities (DLTs) For RP2D: incidence and severity of cumulative safety data, Module 4: Best percent change in tumor size from baseline, ORR, overall response rate, DOR, CBR, tumor marker response, PFS
Endpoint(s): Module 1: • Plasma concentrations of lunresertib with calculation of maximum observed plasma concentration (Cmax), time to maximum observed plasma concentration (Tmax), minimum observed plasma concentration (Cmin), area under the plasma concentration-time curve (AUC), elimination t1/2, and other parameters as appropriate, Module 1: Assessment of biomarkers (e.g., g-H2AX, p-CDK1 Thr14) in pre- and on-treatment biopsies, and circulating tumor DNA (ctDNA) dynamics during treatment., Module 1: Best percent change in tumor size from baseline, objective response rate (ORR), overall response rate, tumor marker response, duration of response (DOR), clinical benefit rate (CBR), available progression-free survival (PFS), Module 2: • Plasma concentrations of lunresertib and RP-3500 with calculation of maximum observed plasma concentration (Cmax), time to maximum observed plasma concentration (Tmax), minimum observed plasma concentration (Cmin), area under the plasma concentration-time curve (AUC), elimination t1/2, and other parameters as appropriate., Module 2: Best percent change in tumor size from baseline, ORR, overall response rate, DOR, CBR, tumor marker response; PFS, Module 3: TEAEs, safety laboratory assessments Best percent change in tumor size from baseline, ORR, overall response rate, DOR, CBR, tumor marker response, PFS Module 3c (if needed) To further characterize the PK of lunresertib tablets and assess preliminary anti-tumor effect., Module 3: Plasma concentrations of lunresertib with calculation of Cmax, Tmax, AUC, elimination t1/2, and other PK parameters as appropriate Best percent change in tumor size from baseline, ORR, overall response rate, DOR, CBR, tumor marker response, PFS, Module 4; Best percent change in tumor size from baseline, ORR, overall response rate, DOR, CBR, tumor marker response, PFS, Module 4: Plasma concentrations of lunresertib and Debio 0123 with calculation of Cmax, Tmax, Cmin, AUC, elimination t1/2, and other parameters as appropriate, Module 4: Assessment of biomarkers (e.g., γ-H2AX, p-CDK1 Thr14, pCDK1 Tyr15) in pre- and on-treatment biopsies, and ctDNA dynamics during treatment

Source: https://euclinicaltrials.eu/ctis-public/view/2023-510063-35-00